EU clinical trial 2024-519190-19-00: A Phase 2 Randomized, Placebo-Controlled, Double-Blind, Parallel-Group Study to Evaluate the Efficacy and Safety of MK-2214 in Participants with Early Alzheimer's Disease
Protocol code: MK-2214-004
Sponsor: Merck Sharp & Dohme LLC (Pharmaceutical company). Phase: Therapeutic exploratory (Phase II). Countries: Spain (ongoing, recruiting), Belgium (ongoing, recruiting), Netherlands (ongoing, recruiting).
Therapeutic area(s): Diseases [C] - Nervous System Diseases [C10]
Gender: Female, Male. Age: 18-64 years, 65+ years. Enrolment: 58.
Status: Ongoing, recruiting. Start date (EU): 2025-10-03. Decision date: 2025-09-30. Results received: No. Last updated: 2026-06-23.
Decision dates by country: ES: 2025-10-08, NL: 2025-09-30, BE: 2025-11-07

Condition(s): Alzheimer’s Disease
Product: MK-2214, Florquinitau F18, Placebo to MK-2214

Primary endpoint: Change from Baseline in Tau Positron Emission Tomography (PET) Standardized Uptake Value Ratio (SUVr), Number of Participants Who Experience One or More Adverse Events (AEs), Number of Participants Who Discontinue Study Intervention Due to an AE
Endpoint(s): Change from Baseline in the Clinical Dementia Rating-Sum of Boxes (CDR-SB) Total Score, Change from Baseline in the Composite Tau PET SUVr in Braak Region III and IV, Change from Baseline in the Composite Tau PET SUVr, Change from Baseline in the Composite Tau PET SUVr in Braak Region I to VI, Change from Baseline in the Alzheimer’s Disease Assessment Scale–Cognitive Subscale13 (ADAS-Cog13) Total Score, Change from Baseline in the Alzheimer’s Disease Cooperative Study Activities of Daily Living for Mild Cognitive Impairment (ADCS-ADL-MCI) Total Score, Change from Baseline in Modified Integrated Alzheimer’s Disease Rating Scale (iADRS) Total Score

Source: https://euclinicaltrials.eu/ctis-public/view/2024-519190-19-00